EU clinical trial 2022-502134-10-00: Phase Ib Dose Finding Study of [177Lu]Lu-NeoB in Combination with RT and TMZ in Newly Diagnosed Glioblastoma and as a Single Agent in Recurrent Glioblastoma
Protocol code: CAAA603C12101
Sponsor: Novartis Pharma AG (Pharmaceutical company). Phase: Human Pharmacology (Phase I)- Other. Countries: Spain (ongoing, recruitment ended), Italy (ended), France (ended), Portugal (ended), Germany (ongoing, recruitment ended).
Therapeutic area(s): Diseases [C] - Neoplasms [C04]
Gender: Female, Male. Age: 18-64 years, 65+ years. Enrolment: 40.
Start date (EU): 2024-05-15. Decision date: 2023-11-27. Results received: No. Last updated: 2026-01-21.
Decision dates by country: IT: 2023-11-29, PT: 2023-11-27, ES: 2023-11-27, DE: 2023-11-29, FR: 2023-11-28

Condition(s): Glioblastoma

Source: https://euclinicaltrials.eu/ctis-public/view/2022-502134-10-00